EU clinical trial 2024-519349-31-00: “Randomized, double-blind clinical trial to assess the efficacy of tranexamic acid in reducing blood loss in patients with hip fracture”.
Protocol code: 2020_TRANEXAMICO
Sponsor: Asociacion Instituto Biogipuzkoa (Patient organisation/association). Phase: Therapeutic use (Phase IV). Countries: Spain (ongoing, recruitment ended).
Therapeutic area(s): Analytical,Diagnostic,Therapeutic Techniques and Equipment [E]-Surgical Procedures, Operative [E04]
Gender: Female, Male. Age: 18-64 years, 65+ years. Enrolment: 644.
Status: Ongoing, recruitment ended. Start date (EU): 2023-05-17. Decision date: 2024-11-11. Results received: No. Last updated: 2025-03-14.

Condition(s): Hip fracture
Product: TRANEXAMIC ACID

Primary endpoint: - Blood transfusion The first result of this study will be the transfusion rate from patient admission to hospital discharge. Patients will be monitored with serial measurements of hemoglobin and hematocrit levels, as well as vital signs and symptoms to assess the need for transfusion.
Endpoint(s): - Hb level: Hb admission, (day 0) Hb day 1, Hb day 2, Hb day 3, Hb preQ, Hb postQ1, Hb postQ2, Hb postQ3, - Hto level, - Occult blood loss: from fracture to admission, and from admission to surgery, - Total loss of blood., . - Adverse events during hospital admission and 3-6-9-12 months postopitalar: DVT, PE, CVA, heart attack, wound infection, urinary infection, respiratory infection, dementia / delirium, wound hematoma-seroma, readmission , reoperation, transfusion reaction, death., . - Charlson comorbidities index., - ASA, - Tto. with anticoagulant, antiplatelet medication., - Epidemiological data: age, sex, weight, height., - Time from trauma to hospital admission (in hours)., - Previous functionality., - Date of admission., - Date of surgical intervention., - Date of hospital discharge, - Hospital stay, - Type of fracture., - Type of surgical intervention., - Functionality per year.

Source: https://euclinicaltrials.eu/ctis-public/view/2024-519349-31-00